EU clinical trial 2022-502727-21-00: A prospective, post-authorisation long-term follow up trial of patients previously treated with imlifidase prior to kidney transplantation, including a non-comparative concurrent reference cohort
Protocol code: 20-HMedIdeS-20
Sponsor: Hansa Biopharma AB (Pharmaceutical company). Phase: Therapeutic confirmatory (Phase III). Countries: Spain (ongoing, recruitment ended), Czechia (ongoing, recruitment ended), Belgium (ended), Sweden (ongoing, recruitment ended), France (ongoing, recruitment ended), Netherlands (ongoing, recruitment ended), Austria (ongoing, recruitment ended), Italy (ongoing, recruitment ended).
Therapeutic area(s): Diseases [C] - Immune System Diseases [C20]
Gender: Female, Male. Age: 18-64 years, 65+ years. Enrolment: 126.
Start date (EU): 2023-07-03. Decision date: 2023-06-02. Results received: No. Last updated: 2026-01-27.
Decision dates by country: AT: 2024-02-05, IT: 2024-02-16, SE: 2024-02-19, BE: 2024-01-29, ES: 2023-06-05, CZ: 2023-06-02, FR: 2024-01-17, NL: 2024-01-22

Condition(s): Highly sensitised patients who have undergone kidney transplantation after Idefirix (imlifidase) administration and less sensitized patients transplanted with compatible kidney transplant, serving as concurrent reference cohort
Product: Idefirix 11 mg powder for concentrate for solution for infusion

Primary endpoint: Graft failure-free survival (%) up to 5 years after imlifidase enabled transplantation(imlifidase cohort only)
Endpoint(s): Graft failure-free survival (%) up to 5 years after transplantation (non-comparativeconcurrent reference cohort only), Graft failure-free survival (%) up to 2 and 3 years after transplantation, Renal function as evaluated by estimated Glomerular Filtration Rate (eGFR) andserum/plasma creatinine levels, Patient survival (%) after transplantation, Graft survival (%) after transplantation, HLA/DSA levels (imlifidase cohort only), ADA levels (imlifidase cohort only), Proportion of patients (%) with biopsy- and serology (DSA)-confirmed AMRs, Proportion of patients (%) with biopsy confirmed CMRs., Treatment of graft rejection episodes, Adverse events (AEs)/serious adverse events (SAEs) suspected to be related toimlifidase treatment (imlifidase cohort only), Ongoing immunosuppressive medication, Comorbidity, Change in patient reported life participation, as measured by the Patient-Reported Outcomes Measurement Information System (PROMIS) Social Health domain “Ability to participate in social roles & activities, PROMIS-SF-8a”, from baseline to 5 years after transplantation

Source: https://euclinicaltrials.eu/ctis-public/view/2022-502727-21-00